EU clinical trial 2024-516841-38-00: MITO 31- A phase II trial of Olaparib in patients with recurrent ovarian cancer wild type for germline and somatic BRCA 1 and 2 genes: The MITO 31 translational study.
Sponsor: IRCCS Istituto Nazionale Tumori Fondazione Pascale (Hospital/Clinic/Other health care facility). Phase: Therapeutic exploratory (Phase II). Countries: Italy (ongoing, recruiting).
Therapeutic area(s): Diseases [C] - Neoplasms [C04]
Gender: Female. Age: 18-64 years, 65+ years. Enrolment: 100.
Status: Ongoing, recruiting. Start date (EU): 2025-01-09. Decision date: 2025-01-09. Results received: No. Last updated: 2026-04-20.

Condition(s): recurrent ovarian cancer wild type for germline and somatic BRCA 1 and 2 genes
Product: Lynparza 150 mg film-coated tablets, Lynparza 100 mg film-coated tablets

Primary endpoint: Primary endpoint -Progression Free Survival
Endpoint(s): Secondary endpoints -Overall Survival -Progression Free Survival 2 (after the subsequent line of treatment) -Toxicity (graded according to CTCAEv 5.0) -Response Rate (RECIST 1.1)

Source: https://euclinicaltrials.eu/ctis-public/view/2024-516841-38-00